EU clinical trial 2024-514064-17-00: C5001001 - A Phase 1/2, Randomized, Double-blind, Placebo-controlled Study to Evaluate the Safety, Tolerability, Pharmacokinetics, and Pharmacodynamics of Single Escalating Doses of PF-07868489 in Healthy Adult Participants And, Additionally, Clinical Activity of Repeat Doses in Participants With Pulmonary Arterial Hypertension
Protocol code: C5001001
Sponsor: Pfizer Inc. (Pharmaceutical company). Phase: Human Pharmacology (Phase I)- Other. Countries: Greece (ended), Belgium (ended), Italy (ended), Germany (ended), Czechia (ended), France (ended), Spain (ended).
Therapeutic area(s): Diseases [C] - Cardiovascular Diseases [C14]
Gender: Female, Male. Age: 18-64 years, 65+ years. Enrolment: 32.
Status: Ended. Start date (EU): 2025-05-23. End date (EU): 2026-07-31. End date: 2026-08-01. Decision date: 2025-04-09. Results received: No. Last updated: 2026-07-16.
Decision dates by country: ES: 2025-04-11, CZ: 2025-04-09, IT: 2025-04-10, BE: 2025-04-09, FR: 2025-07-17, GR: 2025-04-10, DE: 2025-04-11

Condition(s): Pulmonary Arterial Hypertension
Product: PF-07868489, PF-07868489 Placebo

Primary endpoint: Incidence and severity of AE and SAEs., Change from baseline in vital signs., Change from baseline in clinical laboratory values., Change from baseline in ECG parameters (heart rate, QT, QTcF, PR, and QRS intervals)., Change from baseline in Pulmonary Vascular Resistance (PVR) at Week 24
Endpoint(s): PF-07868489 PK parameters after repeat doses; as data permit: Cmin, and t1/2, Incidence of the development of ADA against PF-07868489 following repeat doses., Change from baseline in NT-proBNP at Week 24, Percentage of participants with a change from baseline at 24 Week on (6-minute walk distance) (6MWD) of 30 meters or greater.

Source: https://euclinicaltrials.eu/ctis-public/view/2024-514064-17-00